EU clinical trial 2024-512041-17-00: Efficacy and tolerance of the association of ANIFROLUMAB (300mg) IV every four weeks and phototherapy versus phototherapy in adults with progressive vitiligo: a randomized double blind prospective, non comparative Proof of Concept phase II study - VITANI
Protocol code: CHUBX 2022/03
Sponsor: Centre Hospitalier Universitaire De Bordeaux (Hospital/Clinic/Other health care facility). Phase: Therapeutic exploratory (Phase II). Countries: France (ongoing, recruiting).
Therapeutic area(s): Diseases [C] - Skin and Connective Tissue Diseases [C17]; Diseases [C] - Nervous System Diseases [C10]
Gender: Female, Male. Age: 18-64 years, 65+ years. Enrolment: 48.
Status: Ongoing, recruiting. Start date (EU): 2023-11-27. Decision date: 2024-09-18. Results received: No. Last updated: 2026-01-13.

Condition(s): Patient with non-segmental (symmetrical) vitiligo with a body surface area involved >5% excluding hands and feet
Product: Saphnelo 300 mg concentrate for solution for infusion, PLACEBO

Primary endpoint: Mean variation in percentage of the Vitiligo Area Scoring Index (VASI) score between baseline and week 36.
Endpoint(s): The safety and tolerability of anifrolumab and phototherapy will be assessed based on clinical and biological exams., Mean variation in percentage of the Vitiligo Area Scoring Index (VASI) score between baseline, week 12, 24 and 48., Mean variation in percentage of Face Vitiligo Area Scoring Index (F-VASI) score between baseline , week 12, 24, 36 and 48, Mean variation in percentage of Vitiligo European Task Force (VETF) score between baseline , week 12, 24, 36 and 48, Mean variation in percentage of Vitiligo Extent Score (VES) score between baseline , week 12, 24, 36 and 48, Evolution of the activity of vitiligo will be assessed by measuring the variation in percentage of the Vitiligo Signs of Activity Score (VSAS) between baseline , week 12, 24, 36 and 48, Variation of the Dermatology Life Quality Index (DLQI) between baseline, week 12, 24, 36 and 48, Variation of the Score of the Skindex 29 between inclusion, week 12, 24, 36 and 48, Variation of the Vitiligo Impact Scale (VIPs) between inclusion, week 12, 24, 36 and 48 weeks, Evolution of vitiligo noticeability scale (VNS) score between inclusion, week 12, 24, 36 and 48, Evolution of Physician's Global Impression of Change- Vitiligo (PhGIC-V) between inclusion, week 12, 24, 36 and 48, Evolution of Patient's Global Impression of Change-Vitiligo (PaGIC-V) between inclusion, week 12, 24, 36 and 48, Evolution of Total – Physician Global Vitiligo Assessment (T-PhGVA) between inclusion, week 12, 24, 36 and 48, Evolution of Total – Patient Global Vitiligo Assessment (T-PaGVA) between inclusion, week 12, 24, 36 and 48, Blood inflammatory markers will be measured at inclusion, week 12, 24, 36 weeks using multiplex ELISA on patients’ serum Skin inflammatory markers will be measured at inclusion, 12 and 36 weeks using immunofluorescence on skin biopsies, and transcriptomic analysis on skin biopsies.

Source: https://euclinicaltrials.eu/ctis-public/view/2024-512041-17-00